EU clinical trial 2023-509833-38-00: A Multi-national Phase IIIb, Double-blind, Placebo-controlled Trial to Determine the Safety and Efficacy of STALORAL® Birch 300 IR in Children and Adolescents 5 to 17 Years old with Birch Pollen-induced Allergic Rhinoconjunctivitis with or without Asthma
Protocol code: YOBI/SL79.22
Sponsor: Stallergenes (Pharmaceutical company). Phase: Therapeutic confirmatory (Phase III). Countries: Finland (ended), Slovakia (ended), Germany (ended), Sweden (ended), Austria (ended), Romania (ended), Hungary (ended), Latvia (ended), Poland (ended), France (ended), Bulgaria (ended), Lithuania (ended).
Therapeutic area(s): Diseases [C] - Immune System Diseases [C20]
Gender: Female, Male. Age: 0-17 years. Enrolment: 699.
Status: Ended. Start date (EU): 2023-09-20. End date (EU): 2025-08-06. Decision date: 2024-05-17. Results received: Yes. Last updated: 2025-06-17.
Decision dates by country: SK: 2024-05-20, AT: 2024-05-17, BG: 2024-06-17, FI: 2024-05-17, FR: 2024-05-22, DE: 2024-05-22, HU: 2024-05-17, LV: 2024-05-17, LT: 2024-06-19, RO: 2024-05-21, SE: 2024-05-17, PL: 2024-05-20

Condition(s): Birch Pollen-induced Allergic Rhinoconjunctivitis
Product: Placebo - Staloral birch, oromucosal solution, STALORAL Birke 10 IR/ml und 300 IR/ml, Lösung zur Anwendung in der Mundhöhle, STALORAL Birke 300 IR/ml, Lösung zur Anwendung in der Mundhöhle

Primary endpoint: The primary efficacy endpoint will be the average ARC TCS (TCS0-38) over the entire BPS2.
Endpoint(s): The average CSMS (CSMS0-6) over the entire BPS2., The average ARC DSS (DSS0-18) over the entire BPS2., The average ARC DMS (DMS0-20) over the entire BPS2, The rhinoconjunctivitis-associated functional problems as measured with the RQLQ(S) average overall score for adolescents aged between 12 to 17 years over the entire BPS2., The rhinoconjunctivitis-associated functional problems as measured with the PRQLQ average overall score for children between 6 to 11 years over the entire BPS2. Please refer to Section 10 of the Protocol for a full description of the assessments of efficacy.

Source: https://euclinicaltrials.eu/ctis-public/view/2023-509833-38-00